EU clinical trial 2022-502314-93-00: Study of HRO761 alone or in combination in cancer patients with specific DNA alterations called Microsatellite Instability-High or Mismatch Repair Deficiency
Protocol code: CHRO761A12101
Sponsor: Novartis Pharma AG (Pharmaceutical company). Phase: Human Pharmacology (Phase I)- First administration to humans. Countries: Belgium (ongoing, recruitment ended), Spain (ongoing, recruitment ended), France (ongoing, recruitment ended), Germany (ended), Italy (ongoing, recruitment ended), Sweden (ended), Norway (ended).
Therapeutic area(s): Diseases [C] - Neoplasms [C04]
Gender: Female, Male. Age: 18-64 years, 65+ years. Enrolment: 184.
Start date (EU): 2024-02-05. Decision date: 2023-09-19. Results received: No. Last updated: 2026-07-28.
Decision dates by country: DE: 2023-09-19, BE: 2023-09-19, FR: 2023-09-25, IT: 2023-09-21, ES: 2023-09-20, SE: 2023-09-21, NO: 2023-09-25

Condition(s): MSIhi or dMMR advanced unresectable or metastatic solid tumors

Source: https://euclinicaltrials.eu/ctis-public/view/2022-502314-93-00